EU clinical trial 2022-500861-29-00: A Phase 3, Two-stage, Randomized, Multicenter, Open-label Study Comparing Mezigdomide (CC-92480/BMS-986348), Carfilzomib, and Dexamethasone (MeziKd) Versus Carfilzomib and Dexamethasone (Kd) in Participants with Relapsed or Refractory Multiple Myeloma (RRMM): SUCCESSOR-2
Protocol code: CA057-008
Sponsor: Celgene Corp. (Pharmaceutical company). Phase: Therapeutic confirmatory (Phase III). Countries: Italy (ongoing, recruitment ended), Austria (ongoing, recruitment ended), Germany (ongoing, recruitment ended), Hungary (ongoing, recruitment ended), Spain (ongoing, recruitment ended), Norway (ongoing, recruitment ended), Greece (ongoing, recruitment ended), Denmark (ongoing, recruitment ended), Netherlands (ongoing, recruitment ended), Bulgaria (ongoing, recruitment ended), Romania (ongoing, recruitment ended).
Therapeutic area(s): Diseases [C] - Hemic and Lymphatic Diseases [C15]
Gender: Female, Male. Age: 18-64 years, 65+ years. Enrolment: 238.
Status: Ongoing, recruitment ended. Start date (EU): 2023-01-12. Decision date: 2022-12-06. Results received: No. Last updated: 2026-06-12.
Decision dates by country: HU: 2022-12-20, IT: 2022-12-06, BG: 2024-09-09, NO: 2023-03-01, RO: 2024-09-09, DK: 2022-12-07, GR: 2022-12-06, AT: 2022-12-12, DE: 2022-12-08, ES: 2022-12-20, NL: 2022-12-08

Condition(s): Relapsed or Refractory Multiple Myeloma (RRMM)
Product: CC-92480, CC-92480, CC-92480, DEXAMETHASONE, CC-92480, DEXAMETHASONE, Kyprolis 60 mg powder for solution for infusion, DEXAMETHASONE, CC-92480, CC-92480

Primary endpoint: PFS: Time from randomization to first documentation of progressive disease (PD) according to the International Myeloma Working Group (IMWG) Uniform Response Criteria for Multiple Myeloma or death due to any cause, whichever occurs first.

Source: https://euclinicaltrials.eu/ctis-public/view/2022-500861-29-00